EU clinical trial 2024-510778-26-00: A Phase 2 Multicenter Study of Autologous Tumor Infiltrating Lymphocytes (LN-145) in Patients with Metastatic Non-Small-Cell Lung Cancer
Protocol code: IOV-LUN-202
Sponsor: Iovance Biotherapeutics Inc. (Pharmaceutical company). Phase: Therapeutic exploratory (Phase II). Countries: Germany (ongoing, recruitment ended), Netherlands (ongoing, recruitment ended), France (ongoing, recruiting), Italy (ongoing, recruitment ended), Spain (ongoing, recruitment ended), Belgium (ended).
Therapeutic area(s): Diseases [C] - Neoplasms [C04]
Gender: Female, Male. Age: 18-64 years, 65+ years. Enrolment: 115.
Start date (EU): 2025-12-19. Decision date: 2024-03-25. Results received: No. Last updated: 2026-04-07.
Decision dates by country: BE: 2025-05-20, IT: 2025-06-13, NL: 2024-03-25, DE: 2024-03-27, ES: 2025-06-12, FR: 2025-05-27

Condition(s): Metastatic Non-Small-Cell Lung Cancer
Product: Fludarabine Teva 25 mg/ml solution à diluer pour injection ou perfusion, Fludarabine phosphate 25 mg/ml Concentrate for Solution for Injection or Infusion, LN-145, Proleukin 18 x 106 IE Poeder voor oplossing voor injectie of infusie, Cyclophosphamide Injection 1 g., Fludarabine 50mg Powder For Solution For Injection Or Infusion, Endoxan, Флударабин Актавис 25 mg/ml концентрат за инжекционен или инфузионен разтвор, Fludarabinefosfaat – PCH 25 mg/ml, concentraat voor oplossing voor injectie/infusie, FLUDARABINE, Endoxan 1000 mg milteliai injekciniam tirpalui, Cyclophosphamide 1000 mg Powder for Solution for Injection or Infusion, Fludarabine Accord 25 mg/ml koncentratas injekciniam ar infuziniam tirpalui, Fludarabina Teva 25 mg/ml concentrado para solución para perfusión o inyección EFG, PROLEUKIN® 18 x 106 IU Powder for solution for injection or infusion, Fludarabine Phosphate 25 mg/ml Concentrate for Solution for Injection or Infusion, Proleukin 18 x 106 IE Poeder voor oplossing voor injectie of infusie

Primary endpoint: ORR is defined as the proportion of patients who have a confirmed CR or PR as assessed per RECIST v1.1 by the IRC (Cohorts 1 and 2) or by the Investigator (Cohorts 3, 4 and Retreatment Cohort) from the date of LN145 infusion until disease progression or start of a new anticancer therapy.
Endpoint(s): •ORR (Cohorts 1 and 2), CR rate, DOR, DCR, and PFS (all cohorts) as assessed by the Investigator per RECIST v1.1, • CR rate, DOR, DCR, and PFS as assessed by IRC per RECIST v1.1 (Cohorts 1 and 2), • Overall survival (OS), • Incidence of Grade ≥3 TEAEs and SAEs per CTCAE v5.0 in all patients, • Percentage of successful LN-145 product generated from core biopsies in Cohort 3

Source: https://euclinicaltrials.eu/ctis-public/view/2024-510778-26-00